EU clinical trial 2025-520937-22-00: Autologous Bone Marrow derived cells for the treatment of chronic arterial Limb Ischemia in patients with high risk of amputation
Sponsor: Fundacion Para La Investigacion Y La Innovacion Biosanitaria Del Principado De Asturias (Laboratory/Research/Testing facility). Phase: Therapeutic exploratory (Phase II). Countries: Spain (authorised, recruitment pending).
Therapeutic area(s): Diseases [C] - Cardiovascular Diseases [C14]
Gender: Female, Male. Age: 18-64 years, 65+ years. Enrolment: 21.
Status: Authorised, recruitment pending. Decision date: 2025-02-04. Results received: No. Last updated: 2025-02-04.

Condition(s): advanced chronic ischemia (fontaine III-IV class and Rutherford IV-V), with risk of amputation of at least one limb
Product: SALINE

Primary endpoint: Anatomic and functional changes derived from the vasculo/angiogenesis induced by somatic cell therapy: improve in ankle/brachial index, digit/brachial index, transcutaneous oxygen measurement, ischemic ulcer size and maximum walking distance until claudication

Source: https://euclinicaltrials.eu/ctis-public/view/2025-520937-22-00